EU clinical trial 2023-507114-27-00: A phase 2, randomised, double-blind, vehicle-controlled, dose finding, efficacy, tolerability and safety study of Victorhy in patients with severe hand hyperhidrosis
Protocol code: Dry002-FiH
Sponsor: Dryox Health S.L. (Pharmaceutical company). Phase: Therapeutic exploratory (Phase II). Countries: Spain (ended).
Therapeutic area(s): Diseases [C] - Skin and Connective Tissue Diseases [C17]
Gender: Female, Male. Age: 18-64 years, 65+ years. Enrolment: 60.
Status: Ended. Start date (EU): 2024-02-28. End date (EU): 2025-06-02. Decision date: 2024-01-10. Results received: No. Last updated: 2025-01-22.

Condition(s): Severe primary hand hyperhidrosis
Product: Placebo Tiotropium Bromide Monohydrate Hydroalcoholic gel 0.5% w/w and 0.1% w/w, Victorhy, Victorhy

Primary endpoint: Mean absolute change from Day 1 in gravimetrically measured sweat production at Day 29., Mean change in HDSS at Day 29 from Day 1.
Endpoint(s): To assess the quality of life of the study participants with the Hyperhidrosis Quality of Life Index (HidroQol)., To assess the quality of life of the study participants with the DLQI, To assess the quality of life of the study participants with the EQ-5D-5L questionnaire., Local skin reactions., Number of adverse events per randomisation group., Number of patients within each Adverse Event per randomisation group., Type of Adverse Events per randomisation group., Number of Serious Adverse Events by randomisation group., Type of Serious Adverse Events by randomisation group., Number of Adverse Events of Special Interest by randomisation group., Type of Adverse Events of Special Interest by randomisation group., Treatment-related Adverse Events., Severity of Adverse Events., To assess if on Day 35 there is an increase of 1 or more over the HDSS value obtained on Day 29 (End of Treatment Visit)., The determination of plasma levels of tiotropium bromide at pharmacokinetic steady state.

Source: https://euclinicaltrials.eu/ctis-public/view/2023-507114-27-00